EU clinical trial 2025-522395-92-00: ENGIC 06 (PRODIGE 114) – FFCD 2401 – FRUQUITAS Randomized phase III trial to compare trifluridine/tipiracil + Fruquintinib versus trifluridine/tipiracil alone for metastatic oeso-gastric adenocarcinoma.
Protocol code: ENGIC 06 FRUQUITAS
Sponsor: Fondation Franc.Cancerologie Digestive (Hospital/Clinic/Other health care facility). Phase: Therapeutic confirmatory (Phase III). Countries: France (ongoing, recruiting), Germany (ongoing, recruiting), Spain (ongoing, recruiting).
Therapeutic area(s): Diseases [C] - Neoplasms [C04]
Gender: Female, Male. Age: 18-64 years, 65+ years. Enrolment: 324.
Status: Ongoing, recruiting. Start date (EU): 2025-12-15. Decision date: 2025-11-04. Results received: No. Last updated: 2026-06-19.
Decision dates by country: DE: 2025-11-04, ES: 2026-03-30, FR: 2025-11-10

Condition(s): metastatic oeso-gastric adenocarcinoma
Product: Lonsurf 20 mg/8.19 mg film-coated tablets, Lonsurf 15 mg/6.14 mg film-coated tablets, FRUZAQLA 5 mg hard capsules, FRUZAQLA 1 mg hard capsules

Primary endpoint: Overall survival (OS) and is defined as the time between the date of randomization and the date of death caused by any reason or the date of last news if the patient is alive.
Endpoint(s): Progression-free survival (PFS) is defined as the time between date of randomization and the date of first radiological progression according to RECIST 1.1 or death (whichever occurs first). Patients alive without progression will be censored to the date of last radiologic assessment., Time to progression (TTP) is defined as the time between date of randomization and the date of first radiological progression (according to RECIST v1.1). Patients without progression will be censored at date of last radiologic assessment or date of death. The death will not be considered as an event, Best Objective response rate (ORR) and disease control rate (DCR) is defined as incidence of a complete or partial response during treatment for ORR and a complete or partial or a stability for DCR. ORR and DCR will be provided as overall best response and at 2, 3, 6 and 9 months., Safety profile: TEAEs will be graded according to the NCI-CTCAE v5.0 classifications., Quality of life (QoL) will be evaluated using EORTC QLQ-C30 and the STO22 questionnaires.

Source: https://euclinicaltrials.eu/ctis-public/view/2025-522395-92-00